EU clinical trial 2023-509118-12-00: Sotagliflozin for the treatment of post-bariatric hypoglycaemia: The ONSIDE study
Sponsor: Steno Diabetes Center Copenhagen (Hospital/Clinic/Other health care facility). Phase: Therapeutic exploratory (Phase II). Countries: Denmark (ongoing, recruiting).
Therapeutic area(s): Diseases [C] - Nutritional and Metabolic Diseases [C18]
Gender: Female, Male. Age: 18-64 years, 65+ years. Enrolment: 24.
Status: Ongoing, recruiting. Start date (EU): 2025-11-03. Decision date: 2024-10-14. Results received: No. Last updated: 2026-03-04.

Condition(s): Postbariatric hypoglycaemia
Product: SOTAGLIFLOZIN, PLACEBO

Primary endpoint: Time (% or minutes/per day) in level 2 hypoglycaemia (IG < 3.0 mmol/l) assessed by CGM during the out-patient part (Sotagliflozin 400 mg QD versus placebo)
Endpoint(s): Time (% or minutes/per day) in level 1 hypoglycaemia (IG 3.0–3.9 mmol/l) (out-patient part), Time (% or minutes/per day) below range (IG < 3.9 mmol/l, including readings <3.0 mmol/l) (out-patient part), Time (% or minutes/per day) in range (IG 3.9–10.0 mmol/l) (out-patient part), Time (% or minutes/per day) above tight range (>7.8 mmol/l) (out-patient part), Time (% or minutes/per day) above range (>10.0 mmol/l) (out-patient part), Time (% or minutes/per day) above range (>13.9 mmol/l) (out-patient part), Frequency (no of events/day) of hypoglycaemic events (IG < 3.9 mmol/l, ≥15 min) (out-patient part), Frequency (no of events/day) of level 1 hypoglycaemic events (IG 3.0–3.9 mmol/l, ≥15 min) (out-patient part), Frequency (no of events/day) of level 2 hypoglycaemic events (IG <3.0 mmol/l, ≥15 min) (out-patient part), Frequency (no of events/day) of hyperglycaemic events (>10.0 mmol/l, ≥15 min) (out-patient part), Glycaemic variability assessed as coefficient of variation (CV) (out-patient part), Glycaemic variability assessed as standard deviation (SD) (out-patient part), Glycaemic variability assessed as low blood glucose index (LBGI) (out-patient part), Change in full score of Edinburgh Hypoglycaemia Symptom scale during treatment (EHSS) (out-patient part), Change in full score of fear of hypoglycaemia as assessed by Hypoglycaemia Fear Scale (HFS-II) (out-patient part), Change in full score of quality of life as assessed by the 36-item Short Form health survey (SF-36) (out-patient part), Nadir plasma glucose assessed as the absolute lowest value (in-patient part), Time spent in hypoglycaemia (<3.9 mmol/l) (in-patient part), Time spent in level 1 and level 2 hypoglycaemia (3.0–3.9 and < 3.0 mmol/l, respectively) (in-patient part), Change in full score of Edinburgh Hypoglycemia Symptom scale (in-patient part), Glycaemic rescue intervention due to critically low plasma glucose concentration (≤ 1.8 mmol/l) or onset of marked neuroglycopenic symptoms (in-patient part), Time spent in hyperglycaemia (>7.8, >10.0 and 13.9 mmol/l, respectively) (in-patient part), Peak plasma glucose concentration (in-patient part), Changes in plasma / serum concentrations of insulin, C-peptide, glucagon, GLP-1, GIP, epinephrine, norepinephrine, somatotropin, pancreatic polypeptide, and cortisol measured as area under the curve (AUC) and/or incremental (iAUC) as appropriate, peak values and values at nadir plasma glucose concentration (in-patient part), Rate of gastric emptying as assessed by acetaminophen concentration (paracetamol): Tmax and Cmax (in-patient part)

Source: https://euclinicaltrials.eu/ctis-public/view/2023-509118-12-00